EU clinical trial 2024-515250-25-00: K-SAB trial
Protocol code: K-SAB
Sponsor: Karolinska University Hospital (Hospital/Clinic/Other health care facility). Phase: Human Pharmacology (Phase I)- Other. Countries: Sweden (authorised, recruitment pending).
Therapeutic area(s): Diseases [C] - Neoplasms [C04]
Gender: Female, Male. Age: 18-64 years, 65+ years. Enrolment: 20.
Status: Authorised, recruitment pending. Decision date: 2024-10-25. Results received: No. Last updated: 2024-10-25.

Condition(s): Advanced KRASG12C-mutated non-small cell lung cancer subjects who previosly progressed on at least one prior line of therapy, or who have contraindications for immuno/chemotherapy.

Source: https://euclinicaltrials.eu/ctis-public/view/2024-515250-25-00